EU clinical trial 2024-519342-71-00: A phase 2 double blind placebo controlled study on the efficacy of Bumetanide for cognitive improvement in children and adolescents with Down syndrome
Protocol code: 1042_OPBG_2016
Sponsor: Ospedale Pediatrico Bambino Gesu (Hospital/Clinic/Other health care facility). Phase: Therapeutic exploratory (Phase II). Countries: Italy (ongoing, recruiting).
Therapeutic area(s): Diseases [C] - Congenital, Hereditary, and Neonatal Diseases and Abnormalities [C16]
Gender: Female, Male. Age: 0-17 years. Enrolment: 64.
Status: Ongoing, recruiting. Start date (EU): 2023-01-11. Decision date: 2025-02-03. Results received: No. Last updated: 2026-01-09.

Condition(s): Down Syndrome
Product: Placebo of Burinex tablet, Burinex 1 mg tabletter

Primary endpoint: The primary end-point will be the improvement at the Visual-Object learning test, defined as the increase of 22% in the mean total score occurred after three months of treatment. This improvement is considered clinically significant since the value is similar to the improvement in the healthy population (22,6%), considering the test-retest reliability at three months (Vicari et al., 2007).
Endpoint(s): Secondary end-points will be significant higher improvement in the bumetanide group compared to the placebo group after 3 months in the total scores and subdomain scores of the other episodic memory tasks (Verbal and Visual-Spatial long-term memory, associative memory); the executive function measures (Behavior Rating Inventory Executive Function Second Edition questionnaire – parent report form - BRIEF2), the psychopathological measures, the adaptive level and quality of life

Source: https://euclinicaltrials.eu/ctis-public/view/2024-519342-71-00